EU clinical trial 2024-514628-17-00: A Randomized Placebo controlled Phase I/II Study Evaluating the Safety and Efficacy of Alpha1H in adult patients with non-muscle invasive bladder cancer awaiting transurethral surgery
Protocol code: HP002-001
Sponsor: Hamlet BioPharma AB (Pharmaceutical company). Phase: Phase I and Phase II (Integrated)- Other. Countries: Czechia (ended).
Therapeutic area(s): Diseases [C] - Neoplasms [C04]
Gender: Female, Male. Age: 18-64 years, 65+ years. Enrolment: 76.
Status: Ended. Start date (EU): 2018-05-21. End date (EU): 2025-04-30. Decision date: 2025-01-09. Results received: Yes. Last updated: 2025-01-09.

Condition(s): Non-muscle invasive bladder cancer awaiting transurethral surgery
Product: alpha 1H, Placebo product for Alpha1H

Primary endpoint: Adverse events (AEs); local and systemic Occurrence, intensity and relationship to the active treatment of AEs will be collected during the trial and 30 days after the last active treatment/placebo administration. Safety will also be evaluated by assessment of Vital Signs, ECG and Laboratory parameters, Quantification of cell shedding in urine - Cell shedding into the urine will be used as a biomarker of the tumor response to the Alpha1H peptide-oleate complex. Alpha1H is expected to trigger tumor cell shedding into the urine, based on studies of HAMLET treatment, where intravesical instillations triggered tumor cell shedding in subjects with bladder cancer, The response of the papillary tumors to Alpha1H will be characterized by in vivo imaging during examination by cystoscopy. The resected tumor will be characterized by histopathology. The Alpha1H peptideoleate complex is expected to trigger a reduction in tumor size and a change in shape, based on studies of HAMLET in patients with bladder cancer and results from the murine bladder cancer model
Endpoint(s): Histopathology scoring - Tissue changes will be quantified by histopathology, using established parameters for scoring of Grade and Stage/Invasiveness. Biopsies will be analysed by a designated study pathologist, - Changes in tumor tissue will be characterized by immunohistochemistry for tumor markers, cell death, proliferation, and inflammation, Tissue accumulation of Alpha1H, defined by staining with specific antibodies - Uptake of Alpha1H by tumor tissue will be quantified by staining of tissue sections with specific antibodies. Uptake will be compared to healthy tissue in individual hosts, Tumor response to Alpha1H by gene expression analysis - Changes in cancer-associated pathways will be analysed in tumor biopsies by whole genome transcriptional profiling. Changes in cancerassociated signalling pathways will be compared between the treatment and placebo groups, Urine cytology and apoptosis - Cells in urine will be quantified before and after Alpha1H instillation, using standard cytology techniques and parameters defining tumor grade and stage. - Apoptotic changes in the shed cells will be quantified, as well as other markers of cell death, Proteomic analysis of markers in urine - Changes in protein markers will be quantified by comparing samples obtained before and after the instillation of Alpha1H

Source: https://euclinicaltrials.eu/ctis-public/view/2024-514628-17-00